EU clinical trial 2023-507815-37-00: Does human skeletal muscle possess an epigenetic memory of testosterone
Sponsor: Norges Idrettshoegskole (Educational Institution). Phase: Therapeutic exploratory (Phase II). Countries: Norway (ended).
Therapeutic area(s): Phenomena and Processes [G] - Cell Physiological Phenomena [G04]
Gender: Male. Age: 18-64 years, 65+ years. Enrolment: 40.
Status: Ended. Start date (EU): 2024-08-01. End date (EU): 2026-02-04. Decision date: 2023-11-28. Results received: No. Last updated: 2025-08-14.

Condition(s): Healthy aging, Sarcopenia, Anabolic resistance, Anti-Doping
Product: Nebido 1000 mg/4 ml injeksjonsvæske, oppløsning, Sodium Chloride Fresenius Kabi Italia 0.9 % Solution for infusion

Primary endpoint: Mean differences in fat-free mass, muscle size, and muscle fibre types cross-sectional area (CSA) between placebo or testosterone groups +/- resistance training, measured by DEXA, ultrasound, and muscle biopsies .
Endpoint(s): Differences in myonuclear accretion and permanence and/or the retainment of imprinted epigenetic signatures (DNA methylation) and corresponding gene expression in skeletal muscle between placebo or testosterone groups +/- resistance training., Mean differences in strength, velocity and power between placebo and testosterone groups +/- resistance training, measured by with ultrasound, Keiser leg press machine and IMVC using isokinetic dynamometry

Source: https://euclinicaltrials.eu/ctis-public/view/2023-507815-37-00